EU clinical trial 2023-503950-11-00: Multicenter, randomized, double-blind, Phase III study of intravenous TAD® 600 mg/4 ml solution for injection to evaluate efficacy and safety in preventing myocardial injury in patients with pneumonia
Protocol code: GLT-07-22
Sponsor: Biomedica Foscama Industria Chimico-Farmaceutica S.p.A. (Pharmaceutical company). Phase: Therapeutic confirmatory (Phase III). Countries: Italy (ongoing, recruitment ended).
Therapeutic area(s): Diseases [C] - Cardiovascular Diseases [C14]
Gender: Female, Male. Age: 18-64 years, 65+ years. Enrolment: 178.
Status: Ongoing, recruitment ended. Start date (EU): 2024-05-07. Decision date: 2024-02-19. Results received: No. Last updated: 2025-06-25.
Decision dates by country: IT: 2024-05-13

Condition(s): Myocardial injury in patients affected by pneumonia
Product: TAD 600 mg/4 ml polvere e solvente per soluzione iniettabile., Sodio cloruro B. Braun 0,9% soluzione per infusion.

Primary endpoint: Assessment of the change of levels of high-sensitivity cardiac Troponin (hs-cTn) at V1 versus V0 in the two groups
Endpoint(s): Assessment at V0 versus of V2 of hs-cTn, Assessment at V0 versus V1 and V2 of the following parameters: • Creatine Phosphokinase-MB (CPK-MB)* • C-Reactive Protein (CRP). *CPK-MB will be evaluated only if enough patients have performed the assessment, Electrocardiographic assessment of heart rate and rhythm, atrio-ventricular and intraventricular conduction, ST segment/T-wave, atrial and/or ventricular hyper/hypokinetic arrhythmias, at V0 versus V1 and V2, Echocardiographic assessment of left ventricular Ejection Fraction (EF), left ventricular diastolic and systolic volume values, Pulmonary Artery Systolic Pressure (PASP) at V0 versus V1 and V2, Assessment of Brain Natriuretic Peptide (BNP) or N-Terminal pro B-type Natriuretic Peptide (NT-proBNP) at V0 versus V2, Qualitative and Quantitative Evaluation of all adverse drug reactions and adverse events and their frequency

Source: https://euclinicaltrials.eu/ctis-public/view/2023-503950-11-00